EU clinical trial 2024-516670-29-00: ISKPD-IFM2018-03-Multicenter Open label Phase 2 study of Isatuximab plus Pomalidomide and Dexamethasone with Carfilzomib in Relapsed or Refractory Multiple Myeloma
Sponsor: Centre Hospitalier Universitaire De Poitiers (Hospital/Clinic/Other health care facility). Phase: Therapeutic exploratory (Phase II). Countries: France (ended).
Therapeutic area(s): Diseases [C] - Hemic and Lymphatic Diseases [C15]
Gender: Female, Male. Age: 18-64 years, 65+ years. Enrolment: 90.
Status: Ended. Start date (EU): 2020-09-15. End date (EU): 2025-09-26. Decision date: 2024-08-19. Results received: No. Last updated: 2025-06-02.

Condition(s): Multiple Myeloma
Product: Imnovid 4 mg hard capsules, DEXAMETHASONE, Imnovid 2 mg hard capsules, Kyprolis 60 mg powder for solution for infusion, DEXAMETHASONE, DEXAMETHASONE, Imnovid 1 mg hard capsules, Imnovid 3 mg hard capsules, SARCLISA 20mg/mL concentrate for solution for infusion., DEXAMETHASONE

Primary endpoint: MRD 10-5 incidence rate determined (as the best response obtained at any time point during treatment) as per IMWG criteria by NGS (centrally performed, Pr Avet Loiseau Toulouse Oncopole).
Endpoint(s): Treatment emergent adverse events of IsPd +K will be evaluated according to CTCAE 5.0., To determine Overall Response Rate (ORR, Partial Response and better), Very Good Partial Response (VGPR) + CR rate of IsPd +K as per IMWG criteria and with M protein interference testing. Clinical benefit response rate (CBR, Minor Response (MR) and better) of IsPd +K as per IMWG criteria., Time to response and Response duration for responders as per IMWG criteria., Overall Survival (OS), Progression free survival (PFS), Time To Progression (TTP), Time To Next Therapy (TTNT) and Event Free survival (EFS) of IsPd +K will be evaluated as per IMWG criteria.

Source: https://euclinicaltrials.eu/ctis-public/view/2024-516670-29-00